EU clinical trial 2022-502124-52-00: A Randomized Phase 3, Double-Blind Study of Chemotherapy With or Without Pembrolizumab Followed by Maintenance With Olaparib or Placebo for the First-Line Treatment of BRCA non-mutated Advanced Epithelial Ovarian Cancer (EOC) (KEYLYNK-001 / ENGOT-ov43 / GOG-3036)
Protocol code: MK-7339-001
Sponsor: Merck Sharp & Dohme LLC (Pharmaceutical company). Phase: Therapeutic confirmatory (Phase III). Countries: Germany (ended), Czechia (ended), Hungary (ended), Spain (ended), Italy (ended), Belgium (ended), France (ended), Poland (ended).
Therapeutic area(s): Diseases [C] - Neoplasms [C04]
Gender: Female. Age: 18-64 years, 65+ years. Enrolment: 529.
Status: Ended. Start date (EU): 2018-12-18. End date (EU): 2026-04-14. End date: 2026-04-15. Decision date: 2023-06-30. Results received: No. Last updated: 2026-05-19.
Decision dates by country: ES: 2023-06-30, HU: 2023-06-30, BE: 2023-08-03, PL: 2023-09-13, CZ: 2023-07-03, IT: 2023-07-06, FR: 2023-08-02, DE: 2023-07-17

Condition(s): Advanced epithelial ovarian cancer
Product: CARBOPLATIN, DOCETAXEL, Placebo to pembrolizumab (normal saline/dextrose), Olaparib, KEYTRUDA 25 mg/mL concentrate for solution for infusion, PACLITAXEL, Placebo to Olaparib - Tablet, Olaparib

Primary endpoint: Progression-Free Survival (PFS) Per Response Evaluation Criteria in Solid Tumors Version 1.1 (RECIST 1.1) as Assessed by the Investigator in Participants with Programmed Death-Ligand 1 (PD-L1)-Positive Tumors (Combined Positive Score [CPS]≥10), PFS Per RECIST 1.1 as Assessed by the Investigator in All Participants
Endpoint(s): Overall Survival (OS) in All Participants, OS in Participants with PDL-1 Positive Tumors (CPS≥10), PFS Per RECIST 1.1 as Assessed by Blinded Independent Central Review (BICR) in Participants with PD-L1-Positive Tumors (CPS≥10), PFS Per RECIST 1.1 as Assessed by BICR in All Participants, PFS After Second-line Treatment (PFS2) Following Discontinuation of Study Treatment as Assessed by the Investigator in Participants with PD-L1-Positive Tumors (CPS≥10), PFS2 Following Discontinuation of Study Treatment as Assessed by the Investigator in All Participants, Number of Participants Who Experience an Adverse Event (AE), Number of Participants Who Discontinue Study Treatment Due to an AE, Mean Change from Baseline in Global Health Status/Quality of Life (GHS/QoL) Score Using Questions from the European Organisation for Research and Treatment of Cancer (EORTC) Quality of Life Questionnaire Core 30 (QLQ-C30), Mean Change from Baseline in Abdominal and Gastrointestinal (Abdominal/GI) Symptoms Score Using the EORTC Quality of Life Questionnaire-Ovarian Cancer (QLQ-OV28) Abdominal/GI Symptom Scale, Time to deterioration (TTD) of GHS/QoL score using EORTC QLQ-C30, Time to deterioration (TTD) of abdominal/GI symptoms using EORTC QLQ-OV28, Time to First Subsequent Anti-cancer Treatment (TFST), Time to Second Subsequent Anti-cancer Treatment (TSST), Time to Discontinuation of Study Treatment or Death (TDT), Pathological Complete Response (pCR) Rate

Source: https://euclinicaltrials.eu/ctis-public/view/2022-502124-52-00